EU clinical trial 2023-509769-18-00: A Phase 3, Prospective, Multicenter, Uncontrolled, Open-Label Clinical Study to Determine the Efficacy, Safety, and Tolerability of rVWF with or without ADVATE in the Treatment and Control of Bleeding Episodes, the Efficacy and Safety of rVWF in Elective and Emergency Surgeries, and the Pharmacokinetics (PK) of rVWF in Children Diagnosed with Severe von Willebrand Disease
Protocol code: 071102
Sponsor: Baxalta Innovations GmbH (Pharmaceutical company). Phase: Therapeutic confirmatory (Phase III). Countries: France (ended), Spain (ended), Austria (ended), Belgium (ended), Italy (ended).
Therapeutic area(s): Diseases [C] - Hemic and Lymphatic Diseases [C15]
Gender: Female, Male. Age: 0-17 years. Enrolment: 8.
Status: Ended. Start date (EU): 2017-03-15. End date (EU): 2026-04-17. End date: 2026-04-17. Decision date: 2024-05-30. Results received: No. Last updated: 2025-12-15.
Decision dates by country: AT: 2024-05-31, ES: 2024-05-31, FR: 2024-05-30, BE: 2024-06-04, IT: 2024-06-03

Condition(s): Hereditary severe von Willebrand Disease in children
Product: VEYVONDI 1300 IU powder and solvent for solution for injection., ADVATE 1000 IU powder and solvent for solution for injection., VEYVONDI 650 IU powder and solvent for solution for injection., ADVATE 500 IU powder and solvent for solution for injection.

Primary endpoint: The primary outcome measure is hemostatic efficacy, defined as the number of pediatric subjects with treatment success for vonicog alfa-treated nonsurgical bleeding episodes (using a 4-point scale). Bleeding episode treatment success is defined as a mean efficacy rating score of <2.5.
Endpoint(s): Efficacy: 1. Number of treated nonsurgical bleeding episodes with an efficacy rating of 'excellent' or 'good'., 2. Number of infusions, vonicog alfa units, and ADVATE units (if needed), per bleeding episode., 3. For elective or emergency surgery: an overall assessment of hemostatic efficacy 24 hours after the last perioperative infusion of vonicog alfa, or on Day 14, whichever is earlier, assessed by the Investigator (hematologist) on a 4-point scale., Safety: 1. Incidence and severity of adverse events (AEs) by system organ class (SOC) and preferred term., 2. Incidence of thromboembolic events., 3. Incidence of severe hypersensitivity reactions., 4. Development of neutralizing antibodies to VWF and Factor VIII (FVIII)., 5. Development of total binding antibodies to VWF., 6. Development of antibodies to CHO proteins, murine IgG, and rFurin., PK/PD: 1. Area under the plasma concentration/time curve from 0 to 96 hours post-infusion (AUC0-96h), area under the plasma concentration/time curve from time 0 to infinity (AUC0-∞),, Mean residence time (MRT), maximal plasma concentration (Cmax), time to maximal plasma concentration (Tmax), clearance (CL), incremental recovery (IR), in-vivo recovery (IVR), elimination phase half-life (T1/2), and volume of distribution at steady state (Vss) for VWF:RCo., VWF:Ag and VWF:CB using non-compartmental analysis (NCA) methodology., 2. Area under the plasma concentration/time curve from 0 to 96 hours post-infusion (AUC0-96h) for VWF:Ag and VWF:CB. Point estimates per age cohort will be presented., 3. Area under the plasma concentration/time curve from 0 to 96 hours post-infusion (AUC0-96h) for FVIII activity. Point estimates per age cohort will be presented.

Source: https://euclinicaltrials.eu/ctis-public/view/2023-509769-18-00